EU clinical trial 2022-501180-40-00: International Euro Ewing (iEuroEwing) trial for treatment optimisation in patients with Ewing sarcoma
Protocol code: iEuroEwing
Sponsor: GPOH gGmbH (Patient organisation/association). Phase: Therapeutic confirmatory (Phase III). Countries: Germany (ongoing, recruiting), Greece (ongoing, recruiting), Austria (ongoing, recruiting), Poland (ongoing, recruiting), Belgium (ongoing, recruiting), Finland (ongoing, recruiting), Hungary (ongoing, recruiting), Sweden (ongoing, recruiting).
Therapeutic area(s): Diseases [C] - Neoplasms [C04]
Gender: Female, Male. Age: 0-17 years, 18-64 years. Enrolment: 1351.
Status: Ongoing, recruiting. Start date (EU): 2022-06-17. Decision date: 2023-04-03. Results received: No. Last updated: 2026-07-08.
Decision dates by country: GR: 2023-10-24, FI: 2024-01-22, BE: 2023-12-18, PL: 2024-02-02, AT: 2023-10-02, SE: 2024-02-05, DE: 2023-04-03, HU: 2024-02-07

Condition(s): Ewing Sarcoma
Product: MESNA, FILGRASTIM, IFOSFAMIDE, VINORELBINE, VINCRISTINE SULFATE, CYCLOPHOSPHAMIDE, ETOPOSIDE, VINORELBINE, DOXORUBICIN, CYCLOPHOSPHAMIDE

Primary endpoint: iEuroEwing-SR: Analysis of EFS, iEuroEwing-SR-RT: Analysis of the occurrence of acute skin toxicity CTCAE grade ≥3 during radiotherapy, iEuroEwing-HR: Analysis of EFS
Endpoint(s): iEuroEwing-SR part: Investigation if the maintenance therapy with VinoCyc in a randomised design compared to the standard VDC/IE treatment alone improves overall survival (OS) since randomisation 2, aiming at a 10% increase, and whether the 3-year OS improves compared to historical controls., iEuroEwing-SR-RT part: Investigation if a higher dose of radiation improves local control since randomisation 1 and if a higher dose of radiation improves EFS and OS since randomisation 1., iEuroEwing-HR part: Investigation if the maintenance therapy with VinoCyc in a randomised design compared to the standard VDC/IE treatment alone improves OS, aiming at a 15% increase, and whether the 3-year OS improves compared to historical controls., Toxicity / Safety, Survival outcome, Quality of life, Time to diagnosis, Cancer predisposition, Correlation of histopathological, Biology of Ewing sarcoma

Source: https://euclinicaltrials.eu/ctis-public/view/2022-501180-40-00